EU clinical trial 2024-518972-30-00: A phase I/II open label study to assess safety, feasibility and efficacy of ex vivo expanded, autologous haematopoietic stem and progenitor cell populations that contain CD34+ cells transduced with a lentiviral vector encoding the TCIRG1 cDNA in children with autosomal recessive osteopetrosis caused by mutations in the TCIRG1 gene.
Sponsor: Fondazione Telethon Ets, San Raffaele Hospital (Patient organisation/association, Hospital/Clinic/Other health care facility). Phase: Phase I and Phase II (Integrated)- First administration to humans. Countries: Italy (ongoing, recruiting).
Therapeutic area(s): Diseases [C] - Congenital, Hereditary, and Neonatal Diseases and Abnormalities [C16]
Gender: Female, Male. Age: 0-17 years. Enrolment: 8.
Status: Ongoing, recruiting. Start date (EU): 2026-06-04. Decision date: 2025-08-06. Results received: No. Last updated: 2026-07-14.

Condition(s): Autosomal recessive osteopetrosis caused by mutations in the TCIRG1 gene
Product: Trecondi 1 g powder for solution for infusion, Trecondi 5 g powder for solution for infusion, TEPADINA 15 mg powder for concentrate for solution for infusion, Mozobil 20 mg/ml solution for injection, Trecondi 1 g powder for solution for infusion, Autologous haematopoietic stem and progenitor cell population containing CD34+ cells transduced with a lentiviral vector encoding the TCIRG1 cDNA ex vivo expanded., Trecondi 5 g powder for solution for infusion

Primary endpoint: a. Overall survival following the first ATMP infusion., b. Percentage of patients who experience absence of neutropenia or thrombocytopenia > grade 3 and no regular need of red blood cell (RBC) transfusions as compared to baseline in the patients with long-term engraftment of TCIRG1 LVV-transduced cells, as defined by vector copy number (VCN) > 0.2 in total blood or myeloid cells at 12 months post first ATMP infusion, in the absence of rescue treatments (allogeneic transplantation +/- autologous back-up infusion).
Endpoint(s): Secondary Endpoints of Safety a. Frequency and severity of adverse events (AEs) and serious adverse events (SAEs) attributed to procedures related to the harvesting of HSPCs, to conditioning or to ATMP (0-24 months from the first ATMP administration). b. Absence of malignancy or abnormal clonal proliferation evaluated at 6, 12 and 24 months post first ATMP infusion. c. Absence of Replication Competent Lentivirus at 1, 6, 12 and 24 months post first ATMP infusion., Secondary Endpoints of Feasibility a. Percentage of patients for whom at least the minimum number of autologous HSPCs (≥10x106 CD34+ cells/kg, as specified in the protocol) can be collected for manufacturing. b. Percentage of patients for whom a FT024 product conforming to specifications was manufactured and released., Secondary Endpoints of Efficacy: a. Disability-free survival at baseline and at 24 months post first ATMP infusion, defined as absence of ≥ grade 3 neutropenia/thrombocytopenia, no requirement for chronic transfusion of blood products, no osteomyelitis, no requirement for major neurosurgery, and no pathologic bone fractures during the previous 12 months. b. Time to achieve hematologic recovery§ from the first ATMP infusion., Secondary Endpoints of Efficacy: c. Percentage of patients who do not require a rescue treatment (autologous back-up infusion and/or allogeneic transplant). d. Change in neutrophil counts and platelets levels at 1, 2, 3, 6, 9, 12, 18 and 24 months post first ATMP infusion from baseline. e. Change in monthly RBC and platelets transfusion requirement at 1, 2, 3, 6, 12, 18 and 24 months post first ATMP infusion from baseline., Secondary Endpoints of Efficacy: f. Impact of boost infusion on hematological recovery (neutrophils and platelets levels, RBC and platelets transfusions). g. Engraftment of TCIRG1 LVV-transduced cells, as assessed by longitudinal analysis of vector copy number (VCN) in leukocyte populations from blood and/or bone marrow at 1, 2, 3, 6, 9, 12, 18 and 24 months post first ATMP infusion., Secondary Endpoints of Efficacy: h. Percentage of patients who experience long-term engraftment of TCIRG1 LVV-transduced cells, as defined by vector copy number (VCN) >0.2 in total blood or myeloid cells at 12 months post first ATMP infusion, in the absence of neutropenia or thrombocytopenia > grade 3 and no regular need of RBC transfusions as compared to baseline, in the absence of rescue treatments (allogeneic transplantation +/- autologous back-up infusion), stratified by number of boost., Secondary Endpoints of Efficacy: i. Quality of life (PedsQL 4.0 generic core - Parent-proxy report for Toddler (2-4 years), PedsQL Infant Scales, Stem-cell transplant module), parents reported outcome measures at baseline and at 12 and 24 months after the first ATMP infusion.

Source: https://euclinicaltrials.eu/ctis-public/view/2024-518972-30-00